EU clinical trial 2023-503496-17-00: A Multi-Center, Randomized, Parallel-Group, Phase 2, Masked, Three-Arm Trial to Compare Safety, Tolerability, Efficacy, and Durability of Two Dose Levels of Suprachoroidal Sustained-Release OXU-001 (Dexamethasone Microspheres; DEXAspheres®) Using the Oxulumis® Illuminated Microcatheterization Device Compared with Intravitreal Dexamethasone Implant (OZURDEX®) in Subjects with Diabetic Macular Edema (OXEYE).
Protocol code: OXUCT-102
Sponsor: Oxular IE Limited (Pharmaceutical company). Phase: Therapeutic exploratory (Phase II). Countries: Hungary (ended), Spain (ended).
Therapeutic area(s): Diseases [C] - Eye Diseases [C11]
Gender: Female, Male. Age: 18-64 years, 65+ years. Enrolment: 44.
Status: Ended. End date (EU): 2023-12-11. Decision date: 2023-08-18. Results received: Yes. Last updated: 2023-08-21.
Decision dates by country: HU: 2023-08-18, ES: 2023-08-21

Condition(s): Diabetic Macular Edema (DME)
Product: OXU-001, OZURDEX 700 micrograms intravitreal implant in applicator, OXU-001

Primary endpoint: Both Part A and Part B: Frequency and severity of ocular and systemic adverse events (serious, adverse events of special interest, and treatment-emergent adverse events), Both Part A and Part B: Frequency and severity of device adverse effects (serious adverse device effects and treatment-emergent device adverse effects)
Endpoint(s): Both Part A and Part B: Time from baseline, (Visit 2), to subjects requiring follow-on treatment (per pre-specified criteria)., Both Part A and Part B: Mean Change BCVA (ETDRS) at Week 24 compared to baseline., Both Part A and Part B: Mean Change in central subfield thickness at Week 24 compared to baseline., Both Part A and Part B: Mean Change BCVA (ETDRS) through Week 52 compared to baseline., Both Part A and Part B: Mean Change in central subfield thickness through Week 52 compared to baseline., Part B only: Proportion of subjects requiring follow-on treatment at study visits from Week 12 through Week 52., Part B only: Proportion of subjects with 5-, 10-, or 15-letter (ETDRS) gain of BCVA from week 4 to week 52 compared to baseline., Part B only: Proportion of subjects with 5-, 10-, or 15-letter (ETDRS) loss of BCVA from week 4 to week 52 compared to baseline., Part B only: Proportion of subjects with BCVA >68 letters (ETDRS) at each study visit from week 4 to week 52., Both Part A and Part B: Mean change in NEI VFQ-25 Total Score Week 24, and Week 52 compared to baseline., Part A only - Assess systemic exposure of dexamethasone after administration of OXU-001.

Source: https://euclinicaltrials.eu/ctis-public/view/2023-503496-17-00